EU clinical trial 2023-507876-30-00: Self-administration of subcutaneous Elranatamab in the patients’ homes (ERICA) - An open label, phase two, prospective, non-randomized, sponsor-initiated multi center feasibility study
Sponsor: Odense University Hospital (Hospital/Clinic/Other health care facility). Phase: Therapeutic exploratory (Phase II). Countries: Denmark (ongoing, recruiting).
Therapeutic area(s): Diseases [C] - Hemic and Lymphatic Diseases [C15]
Gender: Female, Male. Age: 18-64 years, 65+ years. Enrolment: 20.
Status: Ongoing, recruiting. Start date (EU): 2024-09-04. Decision date: 2024-07-01. Results received: No. Last updated: 2026-02-02.

Condition(s): Multiple Myeloma
Product: ELRANATAMAB

Primary endpoint: Number of discarded doses, planned doses administered at home, and doses diverted from the patients’ homes to the outpatient clinic evaluated at EoP1, Incidence and severity of AEs and SAEs evaluated at EoP1. AEs/SAEs will be graded according to NCI CTCAE v5.0. CRS and ICANS will be graded according to ASTCT consensus grading
Endpoint(s): Number of infections requiring medical attention or hospitalization assessed at EoP1, Incidence and severity of AEs and SAEs evaluated at EoP2. AEs/SAEs will be graded according to NCI CTCAE v5.0. CRS and ICANS will be graded according to ASTCT consensus grading, Overall Response Rate (ORR) and duration of response at EoP2 with response defined according to IMWG response criteria, PPV and NPV of self-reporting of side effects assessed at EoP1, Time consumption for patients, caregivers, and healthcare professionals assessed at EoP1, Number of unplanned contacts to the healthcare system assessed at EoP1, Number of patients reporting improved or impaired quality of life at C3D1 and EoP1 compared to baseline using the EORTC QLQ-C30 and MY20, Number of patients developing cognitive impairment during elranatamab treatment assessed at EoP1 by the FACT-Cog domain of perceived cognitive impairments, Number of patients developing perceived cognitive impairment, who recover from perceived cognitive impairment based on the following FACT-Cog assessments assessed at EoP1, Number of caregivers experiencing their quality of life to be affected to a higher degree at C3D1 and EoP1 compared to baseline assessed by FROM-16

Source: https://euclinicaltrials.eu/ctis-public/view/2023-507876-30-00